EU clinical trial 2023-510322-32-00: A phase 3 open-label, randomized, controlled study to evaluate the efficacy and safety of petosemtamab compared with investigator’s choice monotherapy treatment in previously treated patients with incurable, metastatic/recurrent head and neck squamous cell carcinoma
Protocol code: MCLA-158-CL02
Sponsor: Merus N.V. (Pharmaceutical company). Phase: Therapeutic confirmatory (Phase III). Countries: Germany (ongoing, recruitment ended), Netherlands (ongoing, recruitment ended), France (ongoing, recruitment ended), Italy (ongoing, recruitment ended), Greece (ongoing, recruitment ended), Belgium (ongoing, recruitment ended), Spain (ongoing, recruitment ended), Poland (ongoing, recruitment ended), Czechia (ended), Hungary (ongoing, recruitment ended), Lithuania (ongoing, recruitment ended), Portugal (ongoing, recruitment ended).
Therapeutic area(s): Diseases [C] - Neoplasms [C04]
Gender: Female, Male. Age: 18-64 years, 65+ years. Enrolment: 385.
Start date (EU): 2025-01-27. Decision date: 2024-08-27. Results received: No. Last updated: 2026-07-02.
Decision dates by country: PL: 2024-08-30, FR: 2025-03-21, DE: 2024-08-27, NL: 2024-09-02, LT: 2025-10-21, IT: 2024-08-28, BE: 2024-09-02, PT: 2025-11-11, GR: 2024-08-28, CZ: 2025-11-11, HU: 2025-10-15, ES: 2024-08-30

Condition(s): patients with incurable, metastatic/recurrent head and neck squamous cell carcinoma
Product: Docetaxel EVER Valinject 20 mg/ml Konzentrat zur Herstellung einer Infusionslösung, Erbitux 5 mg/mL solution for infusion, Methotrexate 25 mg/ml solution for injection

Primary endpoint: Overall survival (OS)
Endpoint(s): 2. Progression Free Survival PFS per RECIST v1.1 as assessed by BICR, 3. DOR per RECIST v1.1 as assessed by BICR, 4. ORR per RECIST v1.1 as assessed by investigator review, 5. PFS per RECIST v1.1 as assessed by investigator review, 6. DOR per RECIST v1.1 as assessed by investigator review, 7. TTR per RECIST v1.1 as assessed by BICR and by Investigator review, 8. CBR per RECIST v1.1 as assessed by BICR and by Investigator review, 9. Proportion of participants experiencing TEAEs, 10. Proportion of participants experiencing serious TEAEs, 11. Proportion of participants who discontinued study treatment due to TEAEs, 12. Proportion of participants who had dose reductions due to TEAEs, 1. Objective response rate (ORR) per RECIST v1.1 as assessed by BICR.

Source: https://euclinicaltrials.eu/ctis-public/view/2023-510322-32-00